EU clinical trial 2024-517854-91-00: Impact of atorvastatin on prostate cancer progression after initiation of androgen deprivation therapy – lipid metabolism as a novel biomarker to predict prostate cancer progression – phase 3, double-blind randomized clinical trial FinnProstata XV. ESTO2.
Protocol code: ESTO2
Sponsor: Pirkanmaan hyvinvointialue (Hospital/Clinic/Other health care facility). Phase: Therapeutic confirmatory (Phase III). Countries: Denmark (ongoing, recruiting), Finland (ongoing, recruiting), Norway (ongoing, recruiting), Estonia (ongoing, recruiting).
Therapeutic area(s): Diseases [C] - Neoplasms [C04]; Diseases [C] - Male Urogenital Diseases [C12]
Gender: Male. Age: 18-64 years, 65+ years. Enrolment: 400.
Status: Ongoing, recruiting. Start date (EU): 2019-08-05. Decision date: 2024-10-15. Results received: No. Last updated: 2026-03-02.
Decision dates by country: FI: 2024-10-15, DK: 2024-10-21, NO: 2024-11-07, EE: 2024-10-21

Condition(s): Metastatic or high-risk recurrent prostate cancer managed with androgen deprivation therapy
Product: Identical capsule as the active product but without any active ingredient., Atorvastatin Krka 40 mg kalvopäällysteiset tabletit

Primary endpoint: Time to disease progression after starting ADT/antiandrogen therapy

Source: https://euclinicaltrials.eu/ctis-public/view/2024-517854-91-00